EU clinical trial 2024-517598-26-00: Effects of the appetite-inducing hormone ghrelin on decision making in healthy volunteers
Protocol code: GHREDECIDE
Sponsor: Linkopings Universitet (Educational Institution). Phase: Therapeutic exploratory (Phase II). Countries: Sweden (ended).
Therapeutic area(s): Psychiatry and Psychology [F] - Behavior and Behavior Mechanisms [F01]; Psychiatry and Psychology [F] - Mental Disorders [F03]; Diseases [C] - Nutritional and Metabolic Diseases [C18]
Gender: Female, Male. Age: 18-64 years. Enrolment: 74.
Status: Ended. Start date (EU): 2019-08-26. End date (EU): 2025-08-13. Decision date: 2024-10-21. Results received: No. Last updated: 2024-10-21.

Condition(s): Gambling disorder
Product: 0.9% Sodium Chloride Intravenous Infusion Solution, Acyl Ghrelin 0.25 mg

Primary endpoint: The dependent variable will be the total number of spins the participant carries out in the Slot Machine task.
Endpoint(s): The dependent variable will be the proportion of trials in which the participant gambled, i.e.; chose the option with an uncertain over that with a certain outcome in the Gambling Task., The dependent variable will be the mean number of pumps per trial, excluding trials where the balloon explodes in the Balloon Analog Risk Task..

Source: https://euclinicaltrials.eu/ctis-public/view/2024-517598-26-00